EU clinical trial 2024-514224-17-00: Ticagrelor monotherapy after coronary stenting in patients with acute myocardial infarction - A prospective single-centre, single-arm phase II study
Protocol code: 5.1
Sponsor: Vaestra Goetalandsregionen (Hospital/Clinic/Other health care facility). Phase: Therapeutic exploratory (Phase II). Countries: Sweden (ended).
Therapeutic area(s): Diseases [C] - Cardiovascular Diseases [C14]
Gender: Female, Male. Age: 18-64 years, 65+ years. Enrolment: 200.
Status: Ended. Start date (EU): 2021-12-03. End date (EU): 2025-06-26. Decision date: 2024-06-11. Results received: Yes. Last updated: 2024-06-11.

Condition(s): Myocardial infarction
Product: Brilique 90 mg film-coated tablets

Primary endpoint: The composite of cardiac death, spontaneous myocardial infarction or definite or probable stent thrombosis within 3 months.
Endpoint(s): Time to the following outcomes at 3- and 12 months (unless specified): Bleeding Academic Research Consortium (BARC) types 3 or 5 bleeding (time-to-event), Definite or probable stent thrombosis or spontaneous target vessel myocardial infarction (time-to-event), Any spontaneous myocardial infarction (time-to-event), All-cause mortality (time-to-event), The composite of cardiac death, spontaneous target vessel myocardial infarction or definite or probable stent thrombosis within 12 months., Platelet reactivity as assessed by the ADP-test (multiplate), at 24 hours and 3 months.

Source: https://euclinicaltrials.eu/ctis-public/view/2024-514224-17-00